EU clinical trial 2024-518276-32-00: A Phase 2, randomized, open-label, active-controlled study of JNJ-90301900 in combination with chemoradiation followed by durvalumab in locally advanced and unresectable Stage III non-small cell lung cancer
Protocol code: 90301900NSC2001
Sponsor: Johnson & Johnson Enterprise Innovation Inc. (Pharmaceutical company). Phase: Therapeutic exploratory (Phase II). Countries: Netherlands (ongoing, recruiting), Spain (ongoing, recruiting), France (ongoing, recruiting).
Therapeutic area(s): Diseases [C] - Neoplasms [C04]
Gender: Female, Male. Age: 18-64 years, 65+ years. Enrolment: 25.
Status: Ongoing, recruiting. Start date (EU): 2025-08-29. Decision date: 2025-03-10. Results received: No. Last updated: 2026-06-18.
Decision dates by country: FR: 2025-03-13, ES: 2025-03-10, NL: 2025-03-10

Condition(s): Locally advanced and unresectable Stage III non-small cell lung cancer
Product: JNJ-90301900

Primary endpoint: ORR using Independent Central Review (ICR) assessments according to RECIST v1.1 (best response)

Source: https://euclinicaltrials.eu/ctis-public/view/2024-518276-32-00